EU clinical trial 2024-519864-42-00: POSITRON EMISSION TOMOGRAPHY/COMPUTED TOMOGRAPHY STUDY FOR SAFETY, TOLERABILITY, BIODISTRIBUTION AND PERFORMANCE OF [68Ga]Ga-DOTA-SIGLEC-9 FOLLOWING A SINGLE INTRAVENOUS ADMINISTRATION IN PATIENTS WITH ACTIVE RHEUMATOID ARTHRITIS, VASCULITIS OR PULMONARY SARCOIDOSIS AS WELL AS RADIATION DOSIMETRY, PLASMA PHARMACOKINETICS, BIODISTRIBUTION OF THE TRACER IN HEALTHY VOLUNTEERS
Sponsor: Turku University Hospital (Hospital/Clinic/Other health care facility). Phase: Phase I and Phase II (Integrated)- First administration to humans. Countries: Finland (authorised, recruitment pending).
Therapeutic area(s): Not possible to specify
Gender: Female, Male. Age: 18-64 years, 65+ years. Enrolment: 26.
Status: Authorised, recruitment pending. Decision date: 2025-01-29. Results received: No. Last updated: 2025-01-29.

Condition(s): active arthritis, vasculitis, pulmonary sarcoidosis

Source: https://euclinicaltrials.eu/ctis-public/view/2024-519864-42-00